EU clinical trial 2024-520083-33-00: Selective laser trabeculoplasty versus eye drops for first line treatment of exfoliation ocular hypertension or glaucoma: a randomised clinical trial
Sponsor: HUS-Yhtymae (Hospital/Clinic/Other health care facility). Phase: Therapeutic use (Phase IV). Countries: Finland (authorised, recruitment pending).
Therapeutic area(s): Diseases [C] - Eye Diseases [C11]
Gender: Female, Male. Age: 18-64 years, 65+ years. Enrolment: 112.
Status: Authorised, recruitment pending. Decision date: 2024-12-19. Results received: No. Last updated: 2024-12-19.

Condition(s): Glaucoma
Product: Taflotan® 15 mikrogrammaa/ml silmätipat, liuos kerta-annospipetissä

Primary endpoint: Primary end point is acceleration of the treatment by adding eye drops.
Endpoint(s): Secondary end points are eye dryness and eye pressure and long term end points are cumulative success of SLT-treatment and need for glaucoma surgery.

Source: https://euclinicaltrials.eu/ctis-public/view/2024-520083-33-00